EU clinical trial 2025-521590-13-00: A Phase 3b, Multicenter, Randomized, Open-Label, Active-Controlled Study to Compare the Efficacy and Safety of Guselkumab versus Risankizumab in the Treatment of Participants with Moderately to Severely Active Crohn’s Disease
Protocol code: CNTO1959CRD3009
Sponsor: Janssen Cilag International (Pharmaceutical company). Phase: Therapeutic confirmatory (Phase III). Countries: Slovakia (ongoing, recruiting), Germany (ongoing, recruiting), Denmark (ongoing, recruiting), France (ongoing, recruiting), Spain (ongoing, recruiting), Italy (ongoing, recruiting), Netherlands (authorised, recruiting), Belgium (ongoing, recruiting), Poland (ongoing, recruiting), Sweden (ongoing, recruiting), Austria (ongoing, recruiting), Czechia (ongoing, recruiting), Hungary (ongoing, recruiting).
Therapeutic area(s): Diseases [C] - Immune System Diseases [C20]
Gender: Female, Male. Age: 18-64 years, 65+ years. Enrolment: 302.
Start date (EU): 2026-05-28. Decision date: 2026-05-27. Results received: No. Last updated: 2026-07-06.
Decision dates by country: DK: 2026-05-28, SE: 2026-05-28, CZ: 2026-05-27, SK: 2026-05-28, FR: 2026-05-28, IT: 2026-05-28, AT: 2026-05-31, DE: 2026-05-29, ES: 2026-06-01, PL: 2026-05-29, BE: 2026-05-29, HU: 2026-06-01, NL: 2026-06-09

Condition(s): Moderately to Severely Active Crohn’s Disease
Product: Guselkumab, Skyrizi 360 mg solution for injection in cartridge, Skyrizi 600 mg concentrate for solution for infusion

Primary endpoint: Deep remission at Week 52

Source: https://euclinicaltrials.eu/ctis-public/view/2025-521590-13-00